EU clinical trial 2025-521755-23-00: Prevention of RSV infection in infants by administering nirsevimab to infants, with or without maternal RSV vaccination: a randomised controlled trial in France as part of the Pregnancy and Infant PrEparedness pLatform IN Europe (PIPELINE)
Sponsor: Centre Hospitalier Annecy Genevois (Hospital/Clinic/Other health care facility). Phase: Therapeutic confirmatory (Phase III). Countries: France (ongoing, recruiting).
Therapeutic area(s): Health Care [N] - Health Care Economics and Organizations [N03]; Diseases [C] - Virus Diseases [C02]; Diseases [C] - Respiratory Tract Diseases [C08]
Gender: Female, Male. Age: 0-17 years, 18-64 years. Enrolment: 2000.
Status: Ongoing, recruiting. Start date (EU): 2026-04-28. Decision date: 2025-10-21. Results received: No. Last updated: 2025-10-21.

Condition(s): Respiratory syncytial virus infection, Bronchiolitis, Respiratory tract infection
Product: Beyfortus 50 mg solution for injection in pre-filled syringe, Beyfortus 100 mg solution for injection in pre-filled syringe, Abrysvo powder and solvent for solution for injection Respiratory syncytial virus vaccine (bivalent, recombinant)

Primary endpoint: Symptomatic RSV respiratory tract infection (RTI) by 12 months of age, confirmed by an approved positive RSV test: RSV reverse transcription polymerase chain reaction (RT-PCR) or a positive RSV antigen test on nasal swabs (fitting for infants) performed in a protocol-approved central or local laboratory. Parents will be encouraged to carry out an RT-PCR test in the event of running or blocked nose, cough, wheeze, or difficulty breathing.
Endpoint(s): RSV RTI by 3 and 6 months of age, Medically-attended (MA)-RSV RTI by 3, 6 and 12 months of age, RSV RTI-associated hospitalisations by 3, 6 and 12 months of age, RSV RTI with SpO2 <90% and/or with need for supplemental O2, RSV RTI-associated deaths by 12 months of age, All-cause RTI by 3, 6 and 12 months of age, All-cause medically attended respiratory tract infections (MA-RTI) by 3, 6 and 12 months of age, All-cause RTI-associated hospitalisations by 3, 6 and 12 months of age, All-cause RTI with SpO2 <90% and/or with need for supplemental O2 by 3, 6 and 12 months of age, All-cause RTI-associated deaths by 12 months of age, MA wheezing with 1 or more episodes by 12 months, RT-PCR Cycle threshold (Ct) value overall and by RSV subtype (RSV-A or RSV-B) for RSV-infection confirmed by RT-PCR by 12 months of age, Serious adverse events (SAEs), grade ≥3 AEs by 12 months of age, All-cause MA-RTI by 12 months post-delivery, SAEs by 12 months post-delivery, Pregnancy loss (miscarriage and stillbirth), Preterm (<37 weeks’ gestation) delivery, Infant low birth weight (<2500g), Acceptability of trial interventions and procedures

Source: https://euclinicaltrials.eu/ctis-public/view/2025-521755-23-00